EU clinical trial 2024-518594-33-00: Hydroxychloroquine in isolated cutaneous mastocytosis patients or indolent systemic mastocytosis with associated skin involvement patients: proof of concept study (HCQMa)
Protocol code: RC31/19/0504
Sponsor: Centre Hospitalier Universitaire De Toulouse (Hospital/Clinic/Other health care facility). Phase: Therapeutic confirmatory (Phase III). Countries: France (ongoing, recruiting).
Therapeutic area(s): Diseases [C] - Skin and Connective Tissue Diseases [C17]
Gender: Female, Male. Age: 18-64 years, 65+ years. Enrolment: 30.
Status: Ongoing, recruiting. Start date (EU): 2021-11-18. Decision date: 2024-10-22. Results received: No. Last updated: 2025-10-03.

Condition(s): mastocytosis
Product: PLAQUENIL 200 mg, comprimé pelliculé

Primary endpoint: The primary endpoint of this study is the change of mast cell activation symptoms as pruritus and/or flushes between the start of treatment and 12 months later.
Endpoint(s): - The difference on mast cell mass between the start of treatment and 12 months later, The difference of other mast cell activation symptoms such as diarrhea, pollakiuria, arthralgia and discomfort between the start of treatment and 12 months later., Tolerance by clinical examination and if necessary paraclinical according to the investigator's decision; tolerance will be assessed during the study period, The correlation of the effectiveness of treatment with the hydroxychloroquine and level of serum HCQ

Source: https://euclinicaltrials.eu/ctis-public/view/2024-518594-33-00